EU clinical trial 2025-523617-29-01: Tolerability and efficacy of treating locally advanced Resectable Oral Cancer with neoadjuvant INtratumoral anti-CTLA4 ImmunoTherapy combined with systemic anti-PD-1 (ROCinIT).
Sponsor: Amsterdam UMC Stichting (Patient organisation/association). Phase: Therapeutic exploratory (Phase II). Countries: Netherlands (authorised, recruitment pending).
Therapeutic area(s): Diseases [C] - Otorhinolaryngologic Diseases [C09]; Diseases [C] - Neoplasms [C04]
Gender: Female, Male. Age: 18-64 years, 65+ years. Enrolment: 24.
Status: Authorised, recruitment pending. Decision date: 2026-07-17. Results received: No. Last updated: 2026-07-17.

Condition(s): Oral cavity squamous cell carcinoma
Product: NIVOLUMAB, IPILIMUMAB

Primary endpoint: To evaluate the tolerability, and efficacy of neoadjuvant intratumoral anti-CTLA-4 combined with systemic anti-PD-1 immunotherapy prior to surgery for locally advanced oral cancer.
Endpoint(s): To compare clinical outcome and toxicity data to Nivolumab alone and systemic anti-CTLA-4 + anti-PD-1., To investigate immune activation in peripheral blood pre-, on- and post-treatment between patients with a CR/MPR and non-responders., To investigate immune activation in the tumor in pre- on- and post-treatment biopsies, and post treatment tdLNs between patients with a CR/MPR and non-responders, To investigate the molecular profile of the tumor (e.g. presence of copy number alterations) in relation to response to the treatment and immune parameters., To assess whether baseline, and/or on treatment MRI perfusion patterns, and treatment induced changes, relate to pathological response and to CD8 T cell infiltration patterns (T-cell excluded versus T-cell inflamed tumor microenvironments), The circulating cell free DNA or RNA kinetics of longitudinal plasma samples at baseline, during neoadjuvant immunotherapy and post-surgery will be linked to pathological response

Source: https://euclinicaltrials.eu/ctis-public/view/2025-523617-29-01